EU clinical trial 2024-513998-48-00: Luteal phase ovarian stimulation with Follitropin delta and dydrogesterone: a randomized cross over pilot trial
Protocol code: CS-10459
Sponsor: Universitair Ziekenhuis Brussel (Hospital/Clinic/Other health care facility). Phase: Therapeutic use (Phase IV). Countries: Belgium (ongoing, recruiting).
Therapeutic area(s): Diseases [C] - Female Urogenital Diseases and Pregnancy Complications [C13]
Gender: Female. Age: 18-64 years. Enrolment: 50.
Status: Ongoing, recruiting. Start date (EU): 2023-02-02. Decision date: 2024-07-31. Results received: No. Last updated: 2026-06-16.

Condition(s): Volutary women who wish to donate their oocytes
Product: REKOVELLE 36 micrograms/1.08 mL solution for injection in a pre-filled pen, Duphaston 10 mg filmomhulde tabletten, Duphaston 10 mg comprimés pelliculés, Duphaston 10 mg Filmtabletten, REKOVELLE 72 micrograms/2.16 mL solution for injection in a pre-filled pen, REKOVELLE 12 micrograms/0.36 mL solution for injection in a pre-filled pen

Primary endpoint: Total number of retrieved COCs
Endpoint(s): Endocrine profile in both treatment groups, Consumption (mcg) of gonadotrophins, Duration of ovarian stimulation, Days of progestin use, Total number of MII oocytes

Source: https://euclinicaltrials.eu/ctis-public/view/2024-513998-48-00